EU clinical trial 2024-514651-15-00: Postmarketing Parallel Randomized Clinical Trial to Determine the Efficacy and Safety of Atropine and DIMS Lenses in the Control of Myopia in a Pediatric Population
Protocol code: 01-DIMS-2021
Sponsor: Hospital Clinico San Carlos (Hospital/Clinic/Other health care facility). Phase: Therapeutic use (Phase IV). Countries: Spain (ongoing, recruitment ended).
Therapeutic area(s): Diseases [C] - Eye Diseases [C11]
Gender: Female, Male. Age: 0-17 years. Enrolment: 111.
Status: Ongoing, recruitment ended. Start date (EU): 2022-02-16. Decision date: 2024-07-18. Results received: No. Last updated: 2024-07-18.

Condition(s): Myopia
Product: ATROPINE

Primary endpoint: Change in refractive error after cycloplegia (with 1% cyclopentolate 3 drops 10 minutes apart; measured after 30 minutes) relative to baseline values., Proportion of patients presenting adverse events
Endpoint(s): Change in axial length in millimetres, relative to baseline values, Change in choroidal and retinal thickness measured on Optical Coherence Tomography (OCT) in μm, relative to baseline values, Change in intraocular pressure in mmHg, relative to baseline values

Source: https://euclinicaltrials.eu/ctis-public/view/2024-514651-15-00